EU clinical trial 2024-513710-35-00: SERORL Effect of aspirin and folic acid for sudden sensorineural hearing loss
Protocol code: APHP230836
Sponsor: Assistance Publique Hopitaux De Paris (Hospital/Clinic/Other health care facility). Phase: Therapeutic confirmatory (Phase III). Countries: France (authorised, recruitment pending).
Therapeutic area(s): Diseases [C] - Otorhinolaryngologic Diseases [C09]
Gender: Female, Male. Age: 18-64 years, 65+ years. Enrolment: 142.
Status: Authorised, recruitment pending. Decision date: 2025-10-17. Results received: No. Last updated: 2026-03-12.

Condition(s): Patients presenting to ENT emergencies with a unilateral sudden sensorineural hearing loss (SSNHL). SSNHL is defined according to the American ENT society guidelines criteria as a subset of SSNHL that is sensorineural in nature, occurs within a 72 hour window, and consists of a decrease in hearing of ≥30 decibels affecting at least 3 consecutive frequencies: 1. A history of an idiopathic and unilateral sudden decrease in hearing > 72 hours and <15 days. 2. A unilateral sensorineural hearing loss demonstrable on a pure‐tone audiogram at the time of entry into the trial. 3. No other neurological signs except the eight cranial nerve defect; no other types of hearing loss as conductive forms of hearing impairment. 4. No history of fluctuating sensorineural hearing loss or otologic disease.
Product: ACIDE FOLIQUE CCD 5 mg, comprimé, PLACEBO D'ASPIRINE PROTECT, ASPIRINE PROTECT 100 mg, comprimé gastro-résistant, PLACEBO D'ACIDE FOLIQUE

Primary endpoint: - Mean PTA (mean of the change of the hearing thresholds for the 3 most affected contiguous frequencies) at D15 as defined by the AAO-HNS: complete recovery with return to less than 10 dB HL of the unaffected ear, no recovery: anything below 10 dB. Partial recovery is between the two extremes.
Endpoint(s): - Maximal speech intelligibility (word recognition) score at D15, M3 and M6., - Mean of pure tones defined as the mean PTA (mean of the change of the hearing thresholds for the 3 most affected contiguous frequencies) at M3 and M6 as defined by the AAO-HNS: complete recovery with return to less than 10 dB HL of the unaffected ear,no recovery: anything below 10 dB. Partial recovery is between the two extremes., - Quality of life will be evaluated with THI and DHI questionnaire at D15, M3 and M6., - Vestibular function assessed at D15, M3 and M6 with: • presence or absence of a spontaneous and positional nystagmus • mean gains of the vestibulo-ocular reflex measured by the vHIT

Source: https://euclinicaltrials.eu/ctis-public/view/2024-513710-35-00